EU clinical trial 2024-511241-19-00: A study to investigate immune challenge induced skin reactions with SAR445399, canakinumab and spesolimab compared with placebo, in healthy participants aged 18 to 55 years
Protocol code: PDY18058
Sponsor: Sanofi-Aventis Recherche & Developpement (Pharmaceutical company). Phase: Human Pharmacology (Phase I)- Other. Countries: Netherlands (ended).
Therapeutic area(s): Diseases [C] - Immune System Diseases [C20]
Gender: Female, Male. Age: 18-64 years. Enrolment: 125.
Status: Ended. Start date (EU): 2024-07-19. End date (EU): 2024-12-05. Decision date: 2024-07-18. Results received: No. Last updated: 2024-08-14.
Decision dates by country: NL: 2024-08-14

Condition(s): Immuun system diseases

Source: https://euclinicaltrials.eu/ctis-public/view/2024-511241-19-00